EU clinical trial 2024-520303-62-00: Bioequivalence clinical trial of two formulations of ezetimibe/atorvastatin
Protocol code: N-EZEATO-24-293
Sponsor: Laboratorios Normon S.A. (Pharmaceutical company). Phase: Human Pharmacology (Phase I)- Bioequivalence Study. Countries: Spain (ended).
Therapeutic area(s): Not possible to specify
Gender: Female, Male. Age: 18-64 years. Enrolment: 36.
Status: Ended. Start date (EU): 2025-03-04. End date (EU): 2025-05-20. Decision date: 2025-02-18. Results received: No. Last updated: 2025-02-18.

Condition(s): Healthy volunteers

Source: https://euclinicaltrials.eu/ctis-public/view/2024-520303-62-00